EU clinical trial 2024-516938-34-00: Safe Stop IPI-NIVO Trial: Early discontinuation of nivolumab upon achieving a (confirmed) complete or partial response in patients with irresectable stage III or metastatic melanoma treated with first-line ipilimumab-nivolumab
Protocol code: Safe Stop IPI-NIVO
Sponsor: Erasmus Universitair Medisch Centrum Rotterdam (Erasmus MC) (Hospital/Clinic/Other health care facility). Phase: Therapeutic confirmatory (Phase III). Countries: Netherlands (ongoing, recruitment ended).
Therapeutic area(s): Diseases [C] - Skin and Connective Tissue Diseases [C17]
Gender: Female, Male. Age: 18-64 years, 65+ years. Enrolment: 80.
Status: Ongoing, recruitment ended. Start date (EU): 2024-09-11. Decision date: 2024-09-11. Results received: No. Last updated: 2024-09-11.

Condition(s): Melanoma
Product: OPDIVO 10 mg/mL concentrate for solution for infusion., YERVOY 5 mg/ml concentrate for solution for infusion, KEYTRUDA 25 mg/mL concentrate for solution for infusion

Primary endpoint: The primary objective of this study is the rate of ongoing response (defined as the absence of disease progression according to RECIST v1 .1 (27) or melanoma-specific mortality) at 12 months after start of treatment in patients with irresectable stage Ill or metastatic melanoma who are treated with first-line ipilimumab-nivolumab and who discontinue nivolumab therapy early (no later than 9 months after treatment commencement with ipilimumab-nivolumab) upon achieving a (confirmed) CR or PR accord
Endpoint(s): A. Patient outcomes: 1. Ongoing response at 24 months after treatment commencement with ipilimumab-nivolumab 2. Response (CR/PR) at different time points (see Table 1 and Figure 1 for follow-up interval) 3. Duration of response (CR/PR) measured until progressive/recurrent disease 4. Melanoma specific survival measured from start of first-line treatment with ipilimumab-nivolumab until melanoma related death 5. OS measured from start of combination treatment with ipilimumab-nivolumab until death, B. Cost-effectiveness analysis 1. Impact on productivity with respect to paid and unpaid work 2. Impact on healthcare resource 3. Impact of early discontinuation of PD-1 blockade on hours of informal care, C. Quality of life assessment in patients with irresectable stage Ill or metastatic melanoma who did not start nivolumab maintenance therapy or discontinued nivolumab maintenance therapy early. Patients will fill out the Qol questionnaires at inclusion, every 12 weeks in the first year of follow up, every 4 months in year 2, every 6 months in year 3 and one set of questionnaires in year 5.

Source: https://euclinicaltrials.eu/ctis-public/view/2024-516938-34-00